EU clinical trial 2023-505557-41-00: Rivaroxaban sotorasib interaction study (the ROSIE-study)
Sponsor: Stichting Radboud University Medical Center (Hospital/Clinic/Other health care facility). Phase: Therapeutic use (Phase IV). Countries: Netherlands (ended).
Therapeutic area(s): Diseases [C] - Cardiovascular Diseases [C14]; Phenomena and Processes [G] - Metabolism [G03]
Gender: Female, Male. Age: 18-64 years. Enrolment: 22.
Status: Ended. Start date (EU): 2023-11-09. End date (EU): 2024-03-21. Decision date: 2023-08-01. Results received: No. Last updated: 2023-08-01.

Condition(s): Healthy subjects
Product: LUMYKRAS 120 mg film-coated tablets, Xarelto 20 mg film-coated tablets

Primary endpoint: The geometric mean ratios of AUC and Cmax of rivaroxaban in absence and presence of sotorasib.
Endpoint(s): Description of the pharmacokinetics of sotorasib in healthy volunteers, by means of standard compartmental or non-compartmental pharmacokinetic methods., Description of the safety of sotorasib and rivaroxaban, graded with the most recent version (v6) of the Common Toxicity Criteria for Adverse Events.

Source: https://euclinicaltrials.eu/ctis-public/view/2023-505557-41-00